EU clinical trial 2023-503765-37-00: An Extension Study Assessing the Long-term Safety and Efficacy of Etranacogene Dezaparvovec (CSL222) Previously Administered to Adult Male Subjects with Hemophilia B
Protocol code: CSL222_3003
Sponsor: CSL Behring LLC (Laboratory/Research/Testing facility). Phase: Phase II and Phase III (Integrated). Countries: Netherlands (ongoing, recruitment ended), Denmark (ongoing, recruitment ended), Belgium (ongoing, recruitment ended), Germany (ongoing, recruitment ended), Ireland (ongoing, recruitment ended), Sweden (ongoing, recruitment ended).
Therapeutic area(s): Diseases [C] - Hemic and Lymphatic Diseases [C15]
Gender: Male. Age: 18-64 years, 65+ years. Enrolment: 28.
Status: Ongoing, recruitment ended. Start date (EU): 2024-09-30. Decision date: 2024-03-04. Results received: No. Last updated: 2026-02-16.
Decision dates by country: DK: 2024-03-04, SE: 2024-06-17, DE: 2024-06-24, NL: 2024-04-19, IE: 2024-06-21, BE: 2024-05-17

Condition(s): Hemophilia B
Product: Hemgenix 1 x 10^13 genome copies/mL concentrate for solution for infusion

Primary endpoint: Number of Participants With Serious Adverse Events (SAEs) and AEs of Special Interest (AESIs), Percentage of Participants with SAEs and AESIs, Number of SAEs and AESIs
Endpoint(s): Annualized Bleeding Rate (ABR), Number of Participants With Zero Total, Spontaneous, Joint, and Traumatic Bleeding Episodes, Endogenous Factor IX (FIX) Activity, Change from Baseline by Visit in Endogenous FIX Activity, Annualized Consumption of FIX Replacement Therapy, Annualized Infusion Rate of FIX Replacement Therapy, Number of Participants Remaining Free of Continuous FIX Prophylaxis, Percentage of Participants Remaining Free of Continuous FIX Prophylaxis, Number of New Target Joints, Percentage Resolution of Pre-existing Target Joints, EuroQol-5 Dimensions-5 Levels (EQ-5D-5L) Index Value, Change From Baseline in EQ-5D-5L Index Value, EQ-5D VAS Score, Change From Baseline in EQ-5D VAS Score, Hemophilia Quality of Life Questionnaire (Hem-A-QoL) Total Score, Change From Baseline in Hem-A-QoL Total Score

Source: https://euclinicaltrials.eu/ctis-public/view/2023-503765-37-00